EU clinical trial 2024-517921-14-00: Randomized Interval Assessment trial of Lu177-Dotatate every 8 versus every 16 weeks in slowly progressive G1-2 advanced midgut neuroendocrine tumors (NETs) to Lower TOxicity.
Protocol code: RLTTio2023
Sponsor: Grupo Espanol De Tumores Neuroendocrinos (Patient organisation/association). Phase: Phase I and Phase II (Integrated)- Other. Countries: Spain (ongoing, recruiting), France (ongoing, recruiting).
Therapeutic area(s): Diseases [C] - Neoplasms [C04]
Gender: Female, Male. Age: 18-64 years, 65+ years. Enrolment: 158.
Status: Ongoing, recruiting. Start date (EU): 2025-05-07. Decision date: 2025-03-17. Results received: No. Last updated: 2025-03-20.
Decision dates by country: FR: 2025-03-20, ES: 2025-03-17

Condition(s): Neuroendocrine tumors of midgut origin
Product: Lutathera 370 MBq/mL solution for infusion

Primary endpoint: The primary endpoint for the RIALTO trial is the rate of Grade 2-5 hematological toxicity (worst per patient) from initiation of treatment with RLT up to 24 months thereafter according to National Cancer Institute Common Terminology Criteria for Adverse Events version 5 (NCI-CTCAE v5)

Source: https://euclinicaltrials.eu/ctis-public/view/2024-517921-14-00